EU clinical trial 2024-516244-25-00: ANACOMP. A RANDOMIZED PHASE III MULTICENTER TRIAL COMPARING THE EFFICACY AND SAFETY OF ANAKINRA VERSUS INTRAVENOUS IMMUNOGLOBULIN (IVIG) RETREATMENT, IN PATIENTS WITH KAWASAKI DISEASE WHO FAILED TO RESPOND TO INITIAL STANDARD IVIG TREATMENT
Protocol code: APHP200009
Sponsor: Assistance Publique Hopitaux De Paris (Hospital/Clinic/Other health care facility). Phase: Therapeutic confirmatory (Phase III). Countries: France (ongoing, recruiting).
Therapeutic area(s): Diseases [C] - Cardiovascular Diseases [C14]
Gender: Female, Male. Age: 0-17 years. Enrolment: 34.
Status: Ongoing, recruiting. Start date (EU): 2026-01-06. Decision date: 2024-11-06. Results received: No. Last updated: 2026-06-18.

Condition(s): Kawasaki disease
Product: Kineret 100 mg/0.67 ml solution for injection in pre-filled syringe., Privigen 100 mg/ml solution for infusion

Primary endpoint: The main criterion-evaluating efficacy in both groups is: the patient must reach a body (axillary (+0.5°C), tympanic, oral) temperature <38˚C within 2 days after initiation of treatment (considering time of the last escalation dose if any) (i.e. a binary outcome: success/failure).
Endpoint(s): Temperature <38˚C within 3 days (72h) after initiation of treatment, Decrease of the CRP values from baseline to day 30 (CRP<6 mg/L at day 30), Reduction in physician assessment of disease activity, on a 10 points scale, of at least to 50% between baseline and day 14., Reduction in patient’s parent’s assessment of disease activity, on a 10 points scale, of to at least 50% between baseline and day 14., Resolution of coronary abnormalities; i.e worst Z score <2.5, by echocardiogram if present at day 45., Adverse events: pain/redness at injection site, bacterial infection, hepatitis, macrophage activation syndrome, severe neutropenia,

Source: https://euclinicaltrials.eu/ctis-public/view/2024-516244-25-00